EU clinical trial 2024-515549-40-00: A Phase 1, Randomized, Double-Blind, Placebo-Controlled study to Evaluate the Safety, Tolerability,and Pharmacokinetics of Single and Multiple Ascending Doses of CBT101 given intranasally in Healthy Male Subjects.
Protocol code: CBT101/OP112923.CER
Sponsor: Ceres Brain Therapeutics (Pharmaceutical company). Phase: Human Pharmacology (Phase I)- First administration to humans. Countries: France (ended).
Therapeutic area(s): Diseases [C] - Nervous System Diseases [C10]
Gender: Male. Age: 18-64 years. Enrolment: 48.
Status: Ended. Start date (EU): 2025-02-21. End date (EU): 2025-09-26. Decision date: 2025-01-21. Results received: No. Last updated: 2025-04-22.

Condition(s): neurological disease

Source: https://euclinicaltrials.eu/ctis-public/view/2024-515549-40-00